EU clinical trial 2024-519370-40-00: B7981094 - A PHASE 3, EXTERNAL AND SYNTHETIC PLACEBO‑CONTROLLED RANDOMIZED STUDY WITH DOSE-UP FOR NON-RESPONDERS TO INVESTIGATE SAFETY AND EFFICACY OF RITLECITINIB 50 MG AND 100 MG ONCE DAILY IN ADULT AND ADOLESCENT PARTICIPANTS 12 YEARS OF AGE AND OLDER WITH ALOPECIA AREATA
Protocol code: B7981094
Sponsor: Pfizer Inc. (Pharmaceutical company). Phase: Therapeutic confirmatory (Phase III). Countries: Poland (ongoing, recruitment ended), Czechia (ongoing, recruitment ended), Spain (ongoing, recruitment ended).
Therapeutic area(s): Diseases [C] - Immune System Diseases [C20]
Gender: Female, Male. Age: 0-17 years, 18-64 years, 65+ years. Enrolment: 74.
Status: Ongoing, recruitment ended. Start date (EU): 2025-07-16. Decision date: 2025-06-06. Results received: No. Last updated: 2026-03-26.
Decision dates by country: ES: 2025-06-06, PL: 2025-06-13, CZ: 2025-07-21

Condition(s): Alopecia areata
Product: PLACEBO FOR PF-06651600-15 CAPSULE, 100 MG, Ritlecitinib Tosilate, PLACEBO FOR PF-06651600-15 CAPSULE, 50 MG, Ritlecitinib tosilate

Primary endpoint: SALT ≤20 response at Week 24
Endpoint(s): SALT ≤20 response at Week 24, PGI-C response, defined as a score of “moderately improved” or “greatly improved” at Week 24, CFB in SALT score at Week 24

Source: https://euclinicaltrials.eu/ctis-public/view/2024-519370-40-00